EU clinical trial 2023-503584-42-00: An open-label, cross-over, multi-site, prospective, phase IIb study of effects on circadian rhythms and quality of life of modifieddual-release hydrocortisone Efmody™ versus immediate-release hydrocortisone in patients with Addison’s Disease
Sponsor: Royal College Of Surgeons In Ireland (Educational Institution). Phase: Therapeutic exploratory (Phase II). Countries: Ireland (ended).
Therapeutic area(s): Diseases [C] - Immune System Diseases [C20]
Gender: Female, Male. Age: 18-64 years, 65+ years. Enrolment: 30.
Status: Ended. Start date (EU): 2023-12-22. End date (EU): 2024-09-09. Decision date: 2023-07-10. Results received: Yes. Last updated: 2024-08-07.

Condition(s): Addison’s Disease
Product: Efmody 10 mg modified-release hard capsules, Hydrocortone 10 mg Tablets, Solu-Cortef Powder for Solution for Injection or Infusion 100 mg, Efmody 5 mg modified-release hard capsules, Hydrocortisone 10 mg Tablets

Primary endpoint: 1. To measure the change from baseline in QoL using the Health-related Quality of Life in Addison's disease (AddiQoL) questionnaire, after 11 weeks treatment with Efmody™ compared with immediate-release hydrocortisone [ Time Frame: Baseline and end of each 11 week treatment period. (see protocol section 10.3.1 for further details)
Endpoint(s): 1. To measure the change from baseline in terms of QoL using the 36-Item Short Form Health Survey (SF-36®) questionnaire, after 11 weeks treatment with Efmody™ compared with immediate-release Hydrocortisone. [ Time Frame: Baseline and end of each 11 week treatment period]. See protocol section 10.3.2 for further details

Source: https://euclinicaltrials.eu/ctis-public/view/2023-503584-42-00